EU clinical trial 2023-506432-32-00: Comparison of treatment completion rates with three short-course rifamycin-based regimens (three months of daily isoniazid plus rifampicin [3HR], three months of once-weekly isoniazid plus rifapentine [3HP], and four months of daily rifampicin [4R]) for treatment of latent tuberculosis infection in patients with end-stage kidney disease: A randomised controlled clinical trial (RIFAKiD-TB Trial)
Protocol code: PI21/004444
Sponsor: Bellvitge University Hospital, Fundacio Institut D'Investigacio Biomedica De Bellvitge IDIBELL (Hospital/Clinic/Other health care facility, Laboratory/Research/Testing facility). Phase: Therapeutic use (Phase IV). Countries: Spain (ended).
Therapeutic area(s): Diseases [C] - Bacterial Infections and Mycoses [C01]
Gender: Female, Male. Age: 18-64 years, 65+ years. Enrolment: 225.
Status: Ended. Start date (EU): 2024-04-11. End date (EU): 2026-03-23. Decision date: 2023-11-28. Results received: No. Last updated: 2026-04-22.

Condition(s): Latent tuberculosis infection in patients with end-stage kidney disease.
Product: Rifaldin 300 mg cápsulas, Rimactán 300 mg cápsulas duras, Cemidón 300 B6, RIFAPENTINE

Primary endpoint: The primary endpoint will be the proportion of participants who complete the assigned treatment regimen, defined as: 1) 90 doses within a maximum of 16 weeks, without interruptions longer than 2 weeks, and no more than on 2 occasions, for the 3HR arm (control), 2) 12 doses within a maximum of 14 weeks, without interruptions longer than 10 days, for the 3HP arm (experimental 1), 3) 120 doses within a maximum of 20 weeks, without interruptions longer than 2 weeks, and no more than on two occasions, for the 4R arm (experimental 2).
Endpoint(s): 1. Proportion of participants who discontinue permanently the assigned treatment because of adverse events, regardless of its relationship to the treatment of the study 2. Proportion of participants., 2. Proportion of participants who discontinue permanently the assigned treatment because of adverse events, related to the treatment of the study., 3. Crude mortality: Number of participants who die while on the study.

Source: https://euclinicaltrials.eu/ctis-public/view/2023-506432-32-00